EU clinical trial 2022-500584-12-00: Efficacy of first line Bortezomib, Rituximab, Ibrutinib (B-RI) for patients with treatment naive Waldenström’s Macroglobulinemia - A MULTICENTER OPEN LABEL, SINGLE ARM EUROPEAN PHASE II STUDY (ECWM-2)
Protocol code: ECWM-2
Sponsor: University Hospital Of Ulm AöR (Hospital/Clinic/Other health care facility). Phase: Therapeutic exploratory (Phase II). Countries: Germany (ongoing, recruitment ended), Greece (ongoing, recruitment ended).
Therapeutic area(s): Diseases [C] - Neoplasms [C04]; Diseases [C] - Hemic and Lymphatic Diseases [C15]
Gender: Female, Male. Age: 18-64 years, 65+ years. Enrolment: 53.
Status: Ongoing, recruitment ended. Start date (EU): 2019-09-11. Decision date: 2024-10-18. Results received: No. Last updated: 2026-05-15.
Decision dates by country: DE: 2024-10-18, GR: 2025-01-22

Condition(s): Waldenström’s Macroglobulinemia
Product: MabThera 500 mg concentrate for solution for infusion, IMBRUVICA 140 mg hard capsules, VELCADE 3.5 mg powder for solution for injection, MabThera 1400 mg solution for subcutaneous injection

Primary endpoint: The primary endpoint is the rate of 1-year progression free survival (1YPFS).
Endpoint(s): The response rates (CR, VGPR, PR, MR) and overall response rate (CR, VGPR, PR, MR) are evaluated 4 weeks after the end of induction treatment., Best response (at least achieving a MR) is determined in the time interval from the start of induction therapy to end of follow-up., Time to best response is defined as the time from the start of induction to best response the patient achieves (CR, VGPR, PR, MR)., Time to first response is defined as the time from the start of induction to first response (MR, PR, VGPR or CR)., Time to treatment failure (TTF) is defined as the time of start of induction treatment to discontinuation of therapy for any reason including death from any cause, progression, toxicity or add-on of new anti-cancer therapy. Patients alive without progression and relapse will be censored at the latest tumor assessment date., Remission duration will be calculated in patients with response (CR, VGPR, PR, MR) from the date of response to the date of progression, relapse or death from any cause. Patients alive without progression and relapse will be censored at the latest tumor assessment date., PFS will be calculated from the date of start of treatment to the following events: the date of progression (as defined in Appendix A) and the date of death if it occurred earlier. Patients alive without progression and relapse will be censored at the latest tumor assessment date., Cause specific survival is defined as the period from the start of induction treatment to death from lymphoma or lymphoma related cause; death unrelated to WM is considered as a competing event., Overall survival is defined as the period from the start of induction treatment to death from any cause. Patients who have not died until the time of the analysis will be censored at their last contact date., Safety including treatment associated adverse events.

Source: https://euclinicaltrials.eu/ctis-public/view/2022-500584-12-00